EU clinical trial 2024-511226-32-00: Impact of prescribing nonsteroidal anti-inflammatory drugs in pleurodesis surgery after pneumothorax: a prospective randomized controlled double-blind multicenter noninferiority study
Sponsor: Centre Hospitalier Universitaire Amiens Picardie (Hospital/Clinic/Other health care facility). Phase: Therapeutic use (Phase IV). Countries: France (ongoing, recruiting).
Therapeutic area(s): Diseases [C] - Respiratory Tract Diseases [C08]
Gender: Female, Male. Age: 18-64 years, 65+ years. Enrolment: 358.
Status: Ongoing, recruiting. Start date (EU): 2025-05-07. Decision date: 2024-07-30. Results received: No. Last updated: 2026-05-28.

Condition(s): pleurodesis surgery for cure of pneumothorax
Product: KETOPROFEN, KETOPROFEN, SODIUM CHLORIDE, NEFOPAM, CELLULOSE, MICROCRYSTALLINE, TRAMADOL, PARACETAMOL

Primary endpoint: Duration of pleural drainage (days).
Endpoint(s): Efficiency of analgesia: - Decimal Numerical Scale (END) for cough at post-operative H0 - END at rest at post-operative H0 - END at rest and cough upon leaving the recovery room - END at rest and cough at H6, D1, D2, Consumption of opioids (equivalent in mg of morphine), Recurrence of ipsilateral pneumothorax at 1 month, 6 months, 1 year, Efficiency of the gesture: - Drain productivity (mL) - Duration of bubbling (days), Post-operative medical and surgical complications : - Pneumonia during hospitalization (nominal) - duration of stay (days) - Need for re-intervention during stay (nominal)

Source: https://euclinicaltrials.eu/ctis-public/view/2024-511226-32-00